EU clinical trial 2024-518210-81-00: A Phase III, Randomised, Open-Label, Sponsor-Blinded, Multicenter Study of Rilvegostomig in Combination with Bevacizumab with or without Tremelimumab as First-line Treatment in Patients With Advanced Hepatocellular Carcinoma (ARTEMIDE-HCC01)
Protocol code: D7029C00001
Sponsor: AstraZeneca AB (Pharmaceutical company). Phase: Therapeutic confirmatory (Phase III). Countries: Italy (ongoing, recruiting), Germany (ongoing, recruiting), France (ongoing, recruiting), Poland (ongoing, recruiting), Spain (ongoing, recruiting), Netherlands (ongoing, recruiting).
Therapeutic area(s): Diseases [C] - Neoplasms [C04]
Gender: Female, Male. Age: 18-64 years, 65+ years. Enrolment: 273.
Status: Ongoing, recruiting. Start date (EU): 2026-03-18. Decision date: 2025-09-30. Results received: No. Last updated: 2026-07-30.
Decision dates by country: IT: 2025-10-01, NL: 2025-10-02, PL: 2025-10-06, ES: 2025-09-30, FR: 2025-10-06, DE: 2025-10-01

Condition(s): Advanced Hepatocellular Carcinoma
Product: Rilvegostomig, MYCOPHENOLATE MOFETIL, INFLIXIMAB, BEVACIZUMAB, ATEZOLIZUMAB, IMJUDO 20 mg/ml concentrate for solution for infusion., IMJUDO 20 mg/ml concentrate for solution for infusion.

Primary endpoint: Overall Survival (OS)
Endpoint(s): PFS, ORR, DoR by BICR per RECIST v1.1

Source: https://euclinicaltrials.eu/ctis-public/view/2024-518210-81-00